EU clinical trial 2023-505791-30-01: A multicentric, randomized, double-blind, placebo-controlled trial to evaluate the efficacy of COLIRIOBCN070660 administered topically in patients with moderately severe to severe non-proliferative diabetic retinopathy
Protocol code: RETISOM
Sponsor: Bcn Peptides S.A. (Pharmaceutical company). Phase: Phase II and Phase III (Integrated). Countries: Spain (ongoing, recruiting).
Therapeutic area(s): Diseases [C] - Eye Diseases [C11]
Gender: Female, Male. Age: 18-64 years, 65+ years. Enrolment: 100.
Status: Ongoing, recruiting. Start date (EU): 2024-04-17. Decision date: 2023-10-25. Results received: No. Last updated: 2026-06-22.

Condition(s): Diabetic Retinopathy
Product: COLIRIOBCN070660, PLACEBO COLIRIOBCN070660

Primary endpoint: Reduction or arrest of the microvascular impairment, based on the quantification of the number of microaneurysms in the central retinal field in patients with moderately severe to severe NPDR assessed by FA.
Endpoint(s): Change on number of haemorrhages (Hmas) in the central retinal field by FA., Change on the number of MAs and Hmas in the central field by CFP., Change on ETDRS severity level assessed by 7-field or ultra-widefield CFP., Changes on Retinal thickness assessed by OCT., Changes on Vessel density assessed by OCTA., Changes on Foveal Avascular Zone (FAZ) growth assessed by OCTA., Changes on visual acuity assessed (BCVA) using the 4-meter ETDRS protocol., Proportion of patients who change by ≥ 2 steps in the ETDRS severity scale., Proportion of patients who change on DR severity level assessed by 7-field or ultra-widefield CFP., Incidence and time to development of proliferative diabetic retinopathy (PDR) assessed by 7-field or ultra-widefield CFP., Incidence and time to development of Central-Involved Diabetic Macular Edema (CI-DME) assessed by OCT., Incidence and time to development of vision-threating complications due to DR (composite of PDR, CI-DME or anterior segment neovascularization (ASNV)) assessed by 7-field or ultra-widefield CFP, OCT, slit lamp examination or indirect ophthalmoscopy., Changes on DR biomarkers

Source: https://euclinicaltrials.eu/ctis-public/view/2023-505791-30-01